EU clinical trial 2022-501474-19-00: A Phase 1/2, First in Human Study of DCC-3116 as Monotherapy and in Combination With RAS/MAPK Pathway Inhibitors in Patients With Advanced or Metastatic Solid Tumors With RAS/MAPK Pathway Mutations
Protocol code: DCC-3116-01-001
Sponsor: Deciphera Pharmaceuticals Inc. (Pharmaceutical company). Phase: Phase I and Phase II (Integrated)- First administration to humans. Countries: Germany (ended), Italy (ended), Spain (ended), France (ended).
Therapeutic area(s): Diseases [C] - Neoplasms [C04]
Gender: Female, Male. Age: 18-64 years, 65+ years. Enrolment: 76.
Status: Ended. End date (EU): 2025-09-12. End date: 2026-03-30. Decision date: 2024-01-11. Results received: No. Last updated: 2025-06-13.
Decision dates by country: DE: 2024-01-15, FR: 2024-01-15, ES: 2024-01-11, IT: 2024-01-15

Condition(s): Non-Small Cell Lung Cancer, Metastatic Solid Tumor, Advanced Solid Tumor
Product: LUMYKRAS 120 mg film-coated tablets, LUMYKRAS 240 mg film-coated tablets

Primary endpoint: The primary efficacy endpoint in the Dose Expansion Phase (Part 2) will be the Objective Response Rate (ORR) based on Investigator Assessment, defined as the proportion of participants who achieve confirmed complete response (CR) or partial response (PR) per RECIST v1.1.
Endpoint(s): Efficacy: The following endpoints assessing efficacy of DCC-3116 will be evaluated: • Duration of Response • Disease Control Rate at 16, 24, and 32 weeks • Time to response • Progression-free-survival • Overall survival (defined as the time from initiation of treatment until death), Pharmacokinetics (PK): PK endpoints will be evaluated for DCC-3116 and sotorasib when administered in combination. These PK parameters will include, but not be limited to: • tmax • Cmax • Cmin • AUC, Safety: Safety endpoints that will be evaluated include the following: • Treatment-emergent adverse event • Serious adverse events • Dose reduction, interruption, or discontinuation of study drugs due to toxicity

Source: https://euclinicaltrials.eu/ctis-public/view/2022-501474-19-00